EU clinical trial 2024-513751-32-00: Bioequivalence of Amoxicillin and Clavulanic Acid 500 mg/125 mg Film-Coated Tablets in Healthy Participants Under Fed Conditions.
Protocol code: BLCL-AMC-01
Sponsor: Bial Portela & Ca S.A. (Pharmaceutical company). Phase: Human Pharmacology (Phase I)- Bioequivalence Study. Countries: Portugal (ended).
Therapeutic area(s): Not possible to specify
Gender: Female, Male. Age: 18-64 years. Enrolment: 48.
Status: Ended. Start date (EU): 2024-07-24. End date (EU): 2024-09-02. Decision date: 2024-07-11. Results received: No. Last updated: 2024-09-17.

Condition(s): No medical condition.

Source: https://euclinicaltrials.eu/ctis-public/view/2024-513751-32-00